EU clinical trial 2024-512866-32-00: Study of RP2 alone and in combination with PD1 Blockade in patients with solid tumours
Protocol code: RP2-001-18
Sponsor: Replimune Group Inc. (Pharmaceutical company). Phase: Phase I and Phase II (Integrated)- First administration to humans. Countries: Spain (ended).
Therapeutic area(s): Diseases [C] - Neoplasms [C04]
Gender: Female, Male. Age: 18-64 years, 65+ years. Enrolment: 32.
Status: Ended. Start date (EU): 2022-07-12. End date (EU): 2026-05-15. End date: 2026-05-16. Decision date: 2024-05-08. Results received: No. Last updated: 2026-04-09.

Condition(s): Solid tumors

Source: https://euclinicaltrials.eu/ctis-public/view/2024-512866-32-00